EU clinical trial 2023-504573-20-00: PLAQUE AND BRAIN INFLAMMATION IN SYMPTOMATIC CAROTID STENOSIS: ROLE OF THE FICOLIN-2; STATEMENT
Protocol code: 69HCL20_0403
Sponsor: Hospices Civils De Lyon (Hospital/Clinic/Other health care facility). Phase: Therapeutic exploratory (Phase II). Countries: France (ended).
Therapeutic area(s): Diseases [C] - Nervous System Diseases [C10]
Gender: Female, Male. Age: 18-64 years, 65+ years. Enrolment: 20.
Status: Ended. Start date (EU): 2023-10-09. End date (EU): 2026-02-03. Decision date: 2023-08-08. Results received: No. Last updated: 2026-01-21.

Condition(s): stroke or transient ischemic attack
Product: GADOTERIC ACID, 18F-DPA-714

Primary endpoint: the correlation between: - Plasma levels of ficolin-2 at day 5, - Metabolic data on [18F]DPA-714 PET/MRI: standardized uptake value (SUV) and Logan distribution volume ratio (DVR) of [18F]DPA-714 in carotids and brain at the time of the PET-Scan imaging (day 5).
Endpoint(s): • Plasma levels of ficolin-2 at day 5 when correlating with morphological data and at day-15 when correlating with histological data, • Morphological data evaluated by the Central Image Reading Board at day 5: - on carotid plaque PET/MRI: presence of intraplaque hemorrhage, lipid-rich necrotic core, and thinning/rupture of the fibrous cap on carotid plaque MRI - on brain PET/MRI: infarct size, hemorrhagic transformation, and blood-brain barrier leakage evaluated by the Central Image Readin

Source: https://euclinicaltrials.eu/ctis-public/view/2023-504573-20-00